EU clinical trial 2025-522281-68-00: CO2 challenge study of NTX-1955 in healthy participants
Protocol code: NTX-1955-102
Sponsor: Newleos Therapeutics Inc. (Pharmaceutical company). Phase: Human Pharmacology (Phase I)- Other. Countries: Netherlands (ongoing, recruiting).
Therapeutic area(s): Psychiatry and Psychology [F] - Mental Disorders [F03]
Gender: Female, Male. Age: 18-64 years. Enrolment: 60.
Status: Ongoing, recruiting. Start date (EU): 2025-08-08. Decision date: 2025-08-06. Results received: No. Last updated: 2025-09-25.

Condition(s): Generalized Anxiety Disorder (GAD)

Source: https://euclinicaltrials.eu/ctis-public/view/2025-522281-68-00